EU clinical trial 2023-506605-19-00: A randomised, controlled trial to investigate the effect of a six-week intensified pharmacological treatment for bipolar depression compared to treatment as usual in subjects who had a first-time treatment failure on their first-line treatment.
Protocol code: INTENSIFY BD
Sponsor: Universitair Medisch Centrum Utrecht (Hospital/Clinic/Other health care facility). Phase: Therapeutic confirmatory (Phase III). Countries: Italy (ongoing, recruiting), Spain (ongoing, recruiting), Germany (ongoing, recruiting), Austria (ongoing, recruiting), Greece (authorised, recruitment pending).
Therapeutic area(s): Psychiatry and Psychology [F] - Mental Disorders [F03]
Gender: Female, Male. Age: 18-64 years, 65+ years. Enrolment: 350.
Start date (EU): 2025-02-11. Decision date: 2024-01-12. Results received: No. Last updated: 2026-07-17.
Decision dates by country: GR: 2024-12-04, AT: 2024-01-15, ES: 2024-01-12, IT: 2024-01-12, DE: 2024-01-12

Condition(s): Bipolar depression
Product: VALPROIC ACID, BUPROPION, QUETIAPINE, ESCITALOPRAM, LITHIUM, SERTRALINE, VENLAFAXINE

Primary endpoint: Mean change from baseline (visit 2) in symptom severity as measured by the MADRS total score at six weeks (visit 4) will be compared between the two treatment arms (EIPT vs. TAU) for the lines of treatment separately (subgroup analysis wherein the focus will be on participants who had a first time treatment failure on their first-line treatment) and for the group as a whole (irrespective of line of treatment).
Endpoint(s): 1.a. Change from baseline (visit 2) in the severity sub-score of the Clinical Global Impression Scale (CGI) at visit 4; EIPT vs TAU. 1.b. Improvement sub-score of the Clinical Global Impression Scale (CGI) at visit 4; EIPT vs TAU., Changes from baseline (visit 2) in total Hospital Anxiety and Depression Scale (HADS) total score and anxiety and depression subscales at visit 4; EIPT vs TAU., Change from baseline (visit 2) in quality of life and functioning measures (Q-LES-Q-SF, LAPS, QLS-100 and SDS ) at visit 4; EIPT vs TAU., Changes from baseline (visit 2) on Trail Making Test, Digit Symbol Substitution Test, Rey Auditory Verbal Learning Test as well as the Perceived Deficits Questionnaire at visit 4; EIPT vs TAU., Presence of symptomatic remission at visit 4; EIPT vs TAU. Remission is defined as a MADRS score ≤ 12., Presence of reported adverse events (related and unrelated to treatment) as measured through General Assessment of Side Effects Scale (GASE) and reported spontaneously at visit 4; EIPT vs TAU., Concomitant medication use throughout the study; EIPT vs TAU., Premature treatment discontinuation before visit 4 and time to treatment discontinuation and reported reason of discontinuation; EIPT vs TAU., Changes on the Columbia-Suicide Severity Rating Scale (C-SSRS) throughout the study; EIPT vs TAU., Occurrence of (hypo)manic episodes throughout the study (including V5); EIPT vs TAU. Scores of 12 or higher means that a participant is in a (hypo)manic episode of bipolar disorder.

Source: https://euclinicaltrials.eu/ctis-public/view/2023-506605-19-00